EU clinical trial 2023-509733-39-00: Evaluation of a therapeutic de-eScalation strategy based on therapeutic drug MOnitOring in chronic non-infectious uveitis Treated witH adalimumab
Protocol code: 23PH187
Sponsor: Centre Hospitalier Universitaire De Saint Etienne (Hospital/Clinic/Other health care facility). Phase: Therapeutic use (Phase IV). Countries: France (authorised, recruitment pending).
Therapeutic area(s): Diseases [C] - Eye Diseases [C11]
Gender: Female, Male. Age: 18-64 years, 65+ years. Enrolment: 320.
Status: Authorised, recruitment pending. Decision date: 2025-02-13. Results received: No. Last updated: 2026-07-02.
Decision dates by country: FR: 2025-04-28

Condition(s): noninfectious uveitis
Product: Humira 40 mg solution for injection in pre-filled pen, Humira 40 mg solution for injection in pre-filled syringe

Primary endpoint: The primary endpoint is a composite of : - Maintenance of complete ophthalmological response at W48 Complete ophthalmological response being defined as the combination, in both eyes, of: absence of inflammatory lesions AND a cellular grade of the anterior chamber and vitreous ≤ 0.5+. - The absence of infection during follow-up for up to 48 weeks.
Endpoint(s): Maintenance of complete ophthalmological response and absence of infection as defined in the primary endpoint section at W12, W24 and W36., Occurrence of a relapse, defined by the presence of any inflammatory lesion and a cellular grade of the anterior chamber and vitreous >0.5+ and/or the occurrence of an infection up to 48 weeks, collected on dedicated forms, notified and validated by the adjudication committee., Anti-ADA antibody positivity and titers at W0, W12, W24, W36 and W48 using a "drug-sensitive" test (i-Tracker anti-ADA) and a "drug-tolerant" test (allowing the absence of false negatives due to the formation of ADA-anti-ADA complexes)., Measurement of quality of life using the National Eye Institute Visual Functioning Questionaire-25 (NEI VFQ-25) composite score at W0, W12, W24, W36 and W48., Incremental cost-effectiveness ratio (ICER)

Source: https://euclinicaltrials.eu/ctis-public/view/2023-509733-39-00